EU clinical trial 2023-504997-39-00: A Phase Ib/III, Open-label, Randomised Study of Capivasertib plus CDK4/6 Inhibitors and Fulvestrant versus CDK4/6 Inhibitors and Fulvestrant in Hormone Receptor-Positive and Human Epidermal Growth Factor Receptor 2-Negative Locally Advanced, Unresectable or Metastatic Breast Cancer (CAPItello-292)
Protocol code: CAPItello-292
Sponsor: AstraZeneca AB (Pharmaceutical company). Phase: Therapeutic confirmatory (Phase III). Countries: France (ongoing, recruitment ended), Denmark (ongoing, recruitment ended), Sweden (ongoing, recruitment ended), Belgium (ongoing, recruitment ended), Poland (ongoing, recruitment ended), Germany (ongoing, recruitment ended), Italy (ongoing, recruitment ended), Spain (ongoing, recruitment ended).
Therapeutic area(s): Diseases [C] - Neoplasms [C04]
Gender: Female, Male. Age: 18-64 years, 65+ years. Enrolment: 214.
Status: Ongoing, recruitment ended. Start date (EU): 2021-06-14. Decision date: 2023-05-22. Results received: No. Last updated: 2026-08-07.
Decision dates by country: BE: 2023-05-22, FR: 2023-05-23, SE: 2023-05-22, DE: 2024-03-07, ES: 2024-03-04, PL: 2023-07-03, IT: 2024-02-16, DK: 2023-05-22

Condition(s): Hormone Receptor-Positive and Human Epidermal Growth Factor Receptor 2-Negative Locally Advanced, Unresectable or Metastatic Breast Cancer
Product: Capivasertib, Verzenios 150 mg film-coated tablets, Verzenios 50 mg film-coated tablets, IBRANCE 100 mg hard capsules, IBRANCE 75 mg hard capsules, IBRANCE 100 mg film-coated tablets, IBRANCE 125 mg hard capsules, Kisqali 200 mg film-coated tablets, IBRANCE 125 mg film-coated tablets, Verzenios 100 mg film-coated tablets, Capivasertib, IBRANCE 75 mg film-coated tablets, Faslodex 250 mg solution for injection.

Primary endpoint: Phase Ib: Safety and tolerability will be evaluated in terms of DLTs, AEs/SAEs, vital signs, clinical chemistry/haematology/glucose metabolism parameters, and ECG parameters.The measures of interest are subject incidence rates, absolute values and change from baseline over time., Phase III: PFS is defined as time from randomisation until progression per RECIST v1.1 as assessed by BICR, or death due to any cause in the overall population, the altered population, and the confirmed non-altered population.
Endpoint(s): Phase Ib: 1. Palbociclib PK parameters: Cmax, AUC0-72h (Cycle 0), AUC0-24h (Cycle 1), Cmin (Cycle 1); Ribociclib PK parameters: Cmax, AUC0-t (Cycle 0), AUC0-24h (Cycle 1), Cmin (Cycle 1); Abemaciclib PK parameters: Cmax, AUC0-t (Cycle 0), AUC0-12h (Cycle 1), Cmin (Cycle 1) 2. Capivasertib PK parameters: Cmax, AUC0-12h, Cmin, 3. Plasma PK parameters derived from a population PK model, as permitted by the data. 4. ORR 5. CBR at 24 weeks 6. DoR 7. PFS, Phase III: For overall population, in altered population and in confirmed non-altered population: 1. OS 2. ORR For overall population only: 3. PFS2 4. DoR 5. CBR at 24 weeks 6. TTD of physical functioning (EORTC QLQ-C30) 7. TTD of GHS/QoL 8. PGI-TT, 8. Plasma concentration of capivasertib pre-dose (Ctrough), and post-dose (C1h, C2h, and C4h) in the overall population (participants randomised to Capivasertib), 9. The number of participants with adverse events (data will include clinical observations, ECG parameters, clinical chemistry, hematology, glucose metabolism parameters and vital signs) 10. The number of participants with serious adverse events (data will include clinical observations, ECG parameters, clinical chemistry, hematology, glucose metabolism parameters and vital signs)

Source: https://euclinicaltrials.eu/ctis-public/view/2023-504997-39-00